EU clinical trial 2023-505836-36-00: I5Q-MC-CGAS: A Randomized, Double-Blind, Placebo-Controlled Study of Galcanezumab in Patients 6 to 17 Years of Age with Episodic Migraine – the REBUILD-1 Study
Protocol code: I5Q-MC-CGAS
Sponsor: Eli Lilly & Co. (Pharmaceutical company). Phase: Therapeutic confirmatory (Phase III). Countries: Denmark (ongoing, recruitment ended), Spain (ongoing, recruitment ended), Italy (ongoing, recruitment ended), Netherlands (ongoing, recruitment ended).
Therapeutic area(s): Diseases [C] - Nervous System Diseases [C10]
Gender: Female, Male. Age: 0-17 years. Enrolment: 64.
Status: Ongoing, recruitment ended. Start date (EU): 2021-03-12. Decision date: 2023-11-20. Results received: No. Last updated: 2026-07-06.
Decision dates by country: IT: 2023-11-27, DK: 2023-11-20, ES: 2023-11-20, NL: 2023-11-24

Condition(s): Migraine
Product: Galcanezumab, Placebo to match LY2951742

Primary endpoint: Change from baseline in the number of monthly migraine headache days

Source: https://euclinicaltrials.eu/ctis-public/view/2023-505836-36-00